EU clinical trial 2024-512003-39-00: A Phase II, single-arm trial to investigate tepotinib in advanced (locally advanced or metastatic) non-small cell lung cancer with MET exon 14 (METex14) skipping alterations or MET amplification (VISION)
Protocol code: MS200095-0022
Sponsor: Merck Healthcare KGaA (Pharmaceutical company). Phase: Therapeutic exploratory (Phase II). Countries: Belgium (ended), France (ended), Poland (ended), Italy (ended), Netherlands (ended), Spain (ended), Germany (ended).
Therapeutic area(s): Diseases [C] - Neoplasms [C04]
Gender: Female, Male. Age: 18-64 years, 65+ years. Enrolment: 26.
Status: Ended. Start date (EU): 2016-07-18. End date (EU): 2024-12-27. Decision date: 2024-07-15. Results received: No. Last updated: 2025-01-15.
Decision dates by country: BE: 2024-07-16, DE: 2024-07-17, ES: 2024-07-23, PL: 2024-07-22, FR: 2024-07-15, NL: 2024-07-16, IT: 2024-07-22

Condition(s): Lung Cancer
Product: Tepotinib

Primary endpoint: Objective response (confirmed CR or PR) determined according to RECIST Version 1.1, based on independent review.
Endpoint(s): 1. Objective response rate assessed as per Investigator, 2. Duration of response as assessed by independent review committee, 3. Duration of response as assessed by investigator, 4. Objective disease control Rate as assessed by independent review committee, 5. Objective disease control Rate as assessed by investigator, 6. Progression free survival as assessed by independent review committee, 7. Progression free survival as assessed by investigator, 8. Overall survival, 9. Number of subjects with TEAEs and deaths, 10. Number of subjects with markedly abnormal vital signs, ECG, physical examination and ECOG PS., 11. Health Related Quality of Life Parameters, 12. Maximum plasma concentration (Cmax) of Drug, 13. Volume of distribution (Vz/F) of drug, 14. Total Clearance (Cl) of drug, 15. Number of subjects with markedly abnormal clinical laboratory tests (hematology and coagulation, biochemistry and urinalysis).

Source: https://euclinicaltrials.eu/ctis-public/view/2024-512003-39-00